EU clinical trial 2024-517189-40-00: A Phase 1 Study of TORL-1-23 in Advanced Cancer
Protocol code: TORL123-001
Sponsor: Torl Biotherapeutics LLC (Pharmaceutical company). Phase: Human Pharmacology (Phase I)- First administration to humans. Countries: Ireland (authorised, recruitment pending).
Therapeutic area(s): Diseases [C] - Neoplasms [C04]
Gender: Female, Male. Age: 18-64 years, 65+ years. Enrolment: 12.
Status: Authorised, recruitment pending. Decision date: 2026-07-06. Results received: No. Last updated: 2026-07-06.

Condition(s): Advanced Cancer

Source: https://euclinicaltrials.eu/ctis-public/view/2024-517189-40-00